EU clinical trial 2024-515280-60-00: An open-label extension study to assess the efficacy and safety of ianalumab with or without study treatment withdrawal in adult participants with lupus nephritis who have completed study treatment in the CVAY736K12301 core study (SIRIUS-LN extension)
Protocol code: CVAY736K12301E1
Sponsor: Novartis Pharma AG (Pharmaceutical company). Phase: Therapeutic confirmatory (Phase III). Countries: Hungary (ongoing, recruiting), Romania (ongoing, recruiting), Czechia (ongoing, recruiting), France (ongoing, recruiting), Spain (ongoing, recruiting), Lithuania (authorised, recruitment pending).
Therapeutic area(s): Diseases [C] - Immune System Diseases [C20]
Gender: Female, Male. Age: 18-64 years, 65+ years. Enrolment: 48.
Start date (EU): 2025-05-29. Decision date: 2025-03-24. Results received: No. Last updated: 2026-06-17.
Decision dates by country: HU: 2025-03-24, RO: 2025-11-03, CZ: 2025-10-08, FR: 2025-10-08, ES: 2025-10-30, LT: 2026-06-17

Condition(s): Lupus nephritis
Product: ENTECAVIR, MYCOPHENOLATE MOFETIL, TENOFOVIR ALAFENAMIDE, VAY736, MYCOPHENOLIC ACID, TENOFOVIR DISOPROXIL

Primary endpoint: Incidence of renal flare, escalation of immunosuppressive medication, or death from Week 144E1 to Week 248, Incidence of TEAEs, SAEs, vital signs and clinical laboratory measurements from the start of treatment in the SIRIUS-LN core study up to EOS of the extension study
Endpoint(s): Incidence of TEAEs, SAEs, vital signs and clinical laboratory measurements from the start of treatment in the SIRIUS-LN core study up to EOS of the extension study, Incidence and titer of anti-ianalumab antibodies in serum (ADA assay) from Week 144E1 up to Week 248, Ianalumab concentration in serum and calculated PK parameters from Week 144E1 up to Week 248

Source: https://euclinicaltrials.eu/ctis-public/view/2024-515280-60-00